EU clinical trial 2022-502619-13-00: A Randomized, Double-Blind, Placebo-Controlled Study to Investigate the Efficacy of Fenebrutinib in Relapsing Multiple Sclerosis
Protocol code: GN43271
Sponsor: F. Hoffmann-La Roche AG (Pharmaceutical company). Phase: Therapeutic exploratory (Phase II). Countries: Czechia (ongoing, recruitment ended), Croatia (ongoing, recruitment ended), Slovakia (ongoing, recruitment ended).
Therapeutic area(s): Diseases [C] - Nervous System Diseases [C10]
Gender: Female, Male. Age: 18-64 years. Enrolment: 67.
Status: Ongoing, recruitment ended. Start date (EU): 2022-01-25. Decision date: 2024-08-01. Results received: No. Last updated: 2026-06-15.
Decision dates by country: SK: 2024-08-01, CZ: 2024-08-01, HR: 2024-08-06

Condition(s): Relapsing Multiple Sclerosis

Primary endpoint: 1. Total number of new gadolinium-enhancing T1 lesions observed on MRI scans of the brain at Weeks 4, 8, and 12
Endpoint(s): 1. Total number of new or enlarging T2- weighted lesions observed on brain MRI at Weeks 4, 8, and 12, 2. Proportion of participants free from any new gadolinium-enhancing T1 lesions and new or enlarging T2-weighted lesions observed on brain MRI at Weeks 4, 8, and 12, 3. Incidence and severity of adverse events, 4. Change from baseline in vital signs, 5. Change from baseline in targeted clinical laboratory test results, 6. Proportion of participants with suicidal ideation or behavior, as assessed by Columbia-Suicide Severity Rating Scale, 7. Plasma concentration of fenebrutinib at specified timepoints

Source: https://euclinicaltrials.eu/ctis-public/view/2022-502619-13-00